EU clinical trial 2024-510663-34-00: An open label, single arm study to evaluate single and multiple dose pharmacokinetics, safety and tolerability, and to explore clinical outcomes of treatment with intravenous (IV) zanamivir in neonates and infants under 6 months of age with confirmed complicated influenza infection.
Protocol code: 200925
Sponsor: Glaxosmithkline Research & Development Limited (Pharmaceutical company). Phase: Therapeutic exploratory (Phase II). Countries: Spain (ended), Italy (ended).
Therapeutic area(s): Diseases [C] - Virus Diseases [C02]
Gender: Female, Male. Age: 0-17 years. Enrolment: 11.
Status: Ended. Start date (EU): 2021-01-29. End date (EU): 2026-04-01. End date: 2026-04-02. Decision date: 2024-04-24. Results received: No. Last updated: 2025-09-15.
Decision dates by country: ES: 2024-04-24, IT: 2024-10-23

Condition(s): Influenza, Human
Product: Dectova 10 mg/mL solution for infusion

Primary endpoint: Area under the serum concentration-time curve (AUC), Maximum serum concentration (Cmax), Clearance (CL), Terminal half-life (t1/2)

Source: https://euclinicaltrials.eu/ctis-public/view/2024-510663-34-00